EU clinical trial 2024-511084-28-00: LA-HCM : Rivaroxaban for Antithrombotic Prevention in Hypertrophic Cardiomyopathy Patients with Abnormal Left Atrial Strain : A Randomized Multicenter Trial
Protocol code: 2024-511084-28
Sponsor: Centre Hospitalier Universitaire De Rennes (Hospital/Clinic/Other health care facility). Phase: Phase III and phase IV (Integrated). Countries: France (ongoing, recruiting).
Therapeutic area(s): Diseases [C] - Cardiovascular Diseases [C14]
Gender: Female, Male. Age: 18-64 years, 65+ years. Enrolment: 532.
Status: Ongoing, recruiting. Start date (EU): 2026-01-12. Decision date: 2025-07-18. Results received: No. Last updated: 2026-04-15.

Condition(s): Hypertrophic Cardiomyopathie
Product: RIVAROXABAN EG 15 mg, comprimé pelliculé, RIVAROXABAN EG 20 mg, comprimé pelliculé

Primary endpoint: All-cause death, myocardial infarction, stroke (including new silent brain infarct documented by comparing a magnetic resonance imaging planned for each participant at baseline and 2 years follow-up) and systemic embolism
Endpoint(s): Bleeding (major and non-major clinically relevant bleeding according to ISTH and BARC (Blending Academic Research Consortium) classification) according to strategy allocation, and exposure to anticoagulant, Atrial arrhythmias identified through ECG/holter monitoring, Left Atrial reservoir strain, Kansas City Cardiomyopathy Questionnaire (KCCQ), Ischemic endpoints (myocardial infarction, stroke (including new silent brain infarct documented by comparing a magnetic resonance imaging planned at baseline and 2 years follow-up, systemic embolism) and bleeding (major and non-major clinically relevant bleeding according to ISTH and BARC classification)

Source: https://euclinicaltrials.eu/ctis-public/view/2024-511084-28-00